EU clinical trial 2023-504538-23-00: A study in healthy men to test how well different doses of BI 3802876 are tolerated
Protocol code: 1517-0001
Sponsor: Boehringer Ingelheim International GmbH (Industry). Phase: Human Pharmacology (Phase I)- First administration to humans. Countries: Belgium (ended).
Therapeutic area(s): Not possible to specify
Gender: Male. Age: 18-64 years. Enrolment: 63.
Status: Ended. Start date (EU): 2023-10-24. End date (EU): 2025-03-20. Decision date: 2023-09-25. Results received: No. Last updated: 2025-03-28.

Condition(s): Healthy volunteer trial

Source: https://euclinicaltrials.eu/ctis-public/view/2023-504538-23-00